EU clinical trial 2024-513444-28-00: Extending the time window for Tenecteplase by Effective RecanalizatioN of bAsilar artery occLusion in patients with POSTerior circulation stroke (POST ETERNAL)
Protocol code: DR230297
Sponsor: Centre Hospitalier Regional Universitaire De Tours (Hospital/Clinic/Other health care facility). Phase: Therapeutic confirmatory (Phase III). Countries: France (authorised, recruitment pending).
Therapeutic area(s): Diseases [C] - Nervous System Diseases [C10]
Gender: Female, Male. Age: 18-64 years, 65+ years. Enrolment: 120.
Status: Authorised, recruitment pending. Decision date: 2024-11-19. Results received: No. Last updated: 2024-11-19.

Condition(s): Acute ischaemic stroke due to basilar artery occlusion.
Product: ACTILYSE, poudre et solvant pour solution injectable et perfusion, ACTILYSE, poudre et solvant pour solution injectable et perfusion, Metalyse 10,000 units powder and solvent for solution for injection, ACTILYSE, poudre et solvant pour solution injectable et perfusion, Metalyse 5 000 units (25 mg) powder for solution for injection

Primary endpoint: The proportion of patients with Modified Rankin Scale (mRS) 0-1 (no disability) or return to baseline mRS (if baseline premorbid mRS =2-3) at 3 months.
Endpoint(s): Proportion of patients with mRS 0-2 or return to baseline mRS at 3 months., Proportion of patients with mRS 0-3 or return to baseline mRS at 3 months., Ordinal analysis of the mRS, merging category 5-6, at 3 months., Proportion of patients achieving early clinical improvement (reduction in acute –72 hour NIHSS score of ≥8 or 72 hour NIHSS 0-1)., Proportion of patients with complete occlusion at baseline who achieve eTICI 2b/3 [14] on initial digital subtraction angiography run prior to thrombectomy., Proportion of patients with sICH defined as parenchymal haemorrhage type 2 (PH2), subarachnoid haemorrhage, and/or intraventricular haemorrhage within 36 of treatment, combined with a neurological deterioration of ≥4 points on the NIHSS from baseline, or leading to death., Proportion of patients with mRS 5-6 at 90 days (severe disability or death)., All-cause mortality within 90 days., Quality of Life assessment (EQ-5D) at 3 and 12 months.

Source: https://euclinicaltrials.eu/ctis-public/view/2024-513444-28-00